EU clinical trial 2023-505542-26-00: A first-in-human, randomized, participant and investigator blinded, placebo-controlled single and multiple ascending dose study to assess the safety, tolerability and pharmacokinetics of HJB647 in healthy participants and otherwise healthy participants with elevated blood pressure, with an open-label CYP3A inhibitor drug-drug interaction part
Protocol code: CHJB647A02101
Sponsor: Novartis Pharma AG (Pharmaceutical company). Phase: Human Pharmacology (Phase I)- First administration to humans. Countries: Netherlands (ended).
Therapeutic area(s): Diseases [C] - Cardiovascular Diseases [C14]
Gender: Female, Male. Age: 18-64 years. Enrolment: 106.
Status: Ended. Start date (EU): 2023-11-30. End date (EU): 2025-11-24. Decision date: 2023-11-20. Results received: No. Last updated: 2025-11-05.

Condition(s): Heart failure (HF)

Source: https://euclinicaltrials.eu/ctis-public/view/2023-505542-26-00